EU clinical trial 2023-509078-45-00: A Phase 2 double blind, randomized, placebo controlled study evaluating the effect of SAR443820 on serum neurofilament levels in participants with multiple sclerosis, followed by an open-label long-term extension period
Protocol code: ACT16753
Sponsor: Sanofi-Aventis Recherche & Developpement (Pharmaceutical company). Phase: Therapeutic exploratory (Phase II). Countries: Spain (ended), Belgium (ended), Germany (ended), Italy (ended), Bulgaria (ended), Poland (ended), France (ended).
Therapeutic area(s): Diseases [C] - Nervous System Diseases [C10]
Gender: Female, Male. Age: 18-64 years. Enrolment: 157.
Status: Ended. Start date (EU): 2022-12-19. End date (EU): 2024-10-11. End date: 2024-11-21. Decision date: 2024-04-24. Results received: Yes. Last updated: 2024-10-18.
Decision dates by country: BE: 2024-04-26, BG: 2024-05-21, FR: 2024-04-26, DE: 2024-05-06, IT: 2024-05-13, ES: 2024-04-24, PL: 2024-05-07

Condition(s): Multiple sclerosis
Product: Matched placebo for product, GADOBUTROL, SAR443820

Primary endpoint: Part A: Week 48 sNfL levels relative to baseline, Part B: Week 96 sNfL levels relative to baseline
Endpoint(s): Part A: Cumulative number of new gadolinium (Gd)-enhancing T1 hyperintense lesions as detected by magnetic resonance imaging (MRI), Part A: Cumulative number of new and/or enlarging T2 hyperintense lesions as detected by MRI, Part A: Time to onset of 12 weeks confirmed disability progression (CDP) from baseline as assessed by the Expanded Disability Status Scale (EDSS) score, Part A: Time to onset of sustained 20% increase in 9-Hole Peg Test (9-HPT) confirmed over at least 12 weeks, Part A: Time to onset of sustained 20% increase in timed 25-foot walk test (T25-FW) confirmed over at least 12 weeks, Part A: Change from baseline in EDSS Plus, Part A: Annualized relapse rate (ARR) of RMS population (relapsing SPMS and RRMS), Part A: Percent change from baseline in brain volume loss (BVL) as detected by brain MRI, Part A: Change from baseline in the volume of slowly expanding lesions (SELs), Part A: Change from baseline in the number of SELs, Part A: Change from baseline in the intensity (T1) of SELs, Part A: Change from baseline in the normalized T1 intensity in lesions, Part A: Change from baseline in the total number of non-enhancing lesions, Part A: Change from baseline in the volume of non-enhancing lesions, Part A: Change from baseline in the number of phase rim lesions (PRL) will be conducted at 3 Tesla (3T) capable sites, Part A: Incidence of adverse event (AE), Part A: Incidence of serious adverse event (SAE), Part A: Incidence of treatment emergent adverse event (TEAE), Part A: Incidence of potentially clinically significant abnormality (PCSA) in laboratory tests, Part A: Plasma concentration of SAR443820, Part B: Percent change from baseline in BVL as detected by brain MRI, Part B: Change from baseline in the volume of slowly expanding lesions (SELs), Part B: Change from baseline in the number of SELs, Part B: Change from baseline in the intensity (T1) of SELs, Part B: Change from baseline in the normalized T1 intensity in lesions, Part B: Change from baseline in the total number of non-enhancing lesions, Part B: Change from baseline in the volume of non-enhancing lesions, Part B: Change from baseline in the number of PRLs (same participants/centers from Part A with 3T capability), Part B: Incidence of AE, Part B: Incidence of SAE, Part B: Incidence of TEAE, Part B: Incidence of potentially clinically significant abnormality (PCSA) in laboratory tests, Part B: Incidence of PCSA in ECG, Part B: Incidence of PCSA in vital signs, Part B: Cumulative number of new Gd-enhancing lesions as detected by T1-weighted MRI, Part B: number of new or enlarging T2-hyperintense lesions on MRI, Part B: ARR of RMS population (relapsing SPMS and RRMS), Part B: Time to onset of composite CDP (CCDP), confirmed over at least 12 weeks (3-month CCDP), by the EDSS Plus composite (EDSS score increase, OR 20% increase in the T25-FW test, OR 20% increase in the 9-HPT), Part B: Time to onset of 12 weeks CDP as assessed by the EDSS score, Part B: Time to onset of sustained 20% increase in 9-HPT confirmed over at least 12 weeks, Part B: Time to onset of sustained 20% increase T25-FW test confirmed over at least 12 weeks, Part B: Change from baseline in EDSS Plus, Part B: Change in Multiple Sclerosis Impact Scale -29 version 2 (MSIS-29v2) physical and psychological domains scoring, Part B: Change in Multiple Sclerosis Walking Scale 12 items (MSWS-12)

Source: https://euclinicaltrials.eu/ctis-public/view/2023-509078-45-00